EU clinical trial 2023-506372-27-00: Botulinumtoxin type A for treatment of Chronic Pelvic Pain Syndrome (CPPS): a phase 3 randomized, double blind, placebo-controlled, multi-center study
Protocol code: CPPS
Sponsor: Ospedale San Raffaele S.r.l. (Hospital/Clinic/Other health care facility). Phase: Therapeutic confirmatory (Phase III). Countries: Italy (authorised, recruitment pending).
Therapeutic area(s): Phenomena and Processes [G] - Reproductive and Urinary Physiological Phenomena [G08]; Analytical, Diagnostic and Therapeutic Techniques and Equipment [E] - Therapeutics [E02]
Gender: Female, Male. Age: 18-64 years, 65+ years. Enrolment: 110.
Status: Authorised, recruitment pending. Decision date: 2025-06-17. Results received: No. Last updated: 2026-04-24.

Condition(s): Adult patients, male or female, with chronic pelvic pain syndrome (CPPS).
Product: Matching placebo identical to IMP, BOTOX 100 Allergan Units Powder for Solution for Injection

Primary endpoint: Proportion of patients considered to be responders (defined as ≥ 30% reduction in pain intensity compared to the baseline) at week 4 in the BoNT/A-treated group versus the placebo group. Pain intensity is rated with Pain Intensity Numeric Rating Scale (PI-NRS) on a 7-day pain diary (mean of the worst daily pain intensity over the 7 preceding days) compared to a 7-day baseline period
Endpoint(s): Proportion of responders in the BoNT/A-treated group versus the placebo group at other scheduled assessments (i.e. week 2, 6, 8, 10, 12, 14, 16, 18, 20, 22, 24), Change (%) in amount of rescue medication taken, evaluated on a 7-day diary filled-out the week before each scheduled visits (i.e. week 4, 8, 12, 16, 20, 24) compared to the baseline, Change in DN4 questionnaire and in Pelvic Floor Muscles Hyperalgesia (PFMH) score at each scheduled visits (i.e. week 4, 8, 12, 16, 20, 24) compared to the baseline, Incidence of adverse events (AEs) (total AEs, new/or worsened urinary incontinence, new/or worsened urinary retention, new/or worsened fecal incontinence, new/or worsened constipation, other AEs) (at each follow-up visit and phone interview), Severity of AEs (mild, moderate, severe) (at each follow-up visit and phone interview), Change in International Prostate Symptom Score (IPSS), Wexner score, Female Sexual Distress Scale (FSDS) and International Index of Erectile Function (IIEF) score at scheduled visits (i.e. week 4, 8, 12, 16, 20, 24) compared to the baseline, Change in Short Form 12 Health Survey (SF-12) score at scheduled visits (i.e. week 4, 8, 12, 16, 20, 24) compared to the baseline

Source: https://euclinicaltrials.eu/ctis-public/view/2023-506372-27-00